EU clinical trial 2025-523079-44-00: HighLiGHts - A Pivotal, Parallel-Arm, Phase 3, Open-Label, Active-controlled, Global, Multicenter, Randomized Basket Trial Investigating the Efficacy and Safety of Once-weekly Lonapegsomatropin Compared to Daily Somatropin in Prepubertal Children and Adolescents with Growth Failure or Short Stature due to Growth Hormone Sufficient Disorders – Turner Syndrome, SHOX Deficiency, Small for Gestational Age, and Idiopathic Short Stature
Protocol code: ASND0047
Sponsor: Ascendis Pharma Endocrinology Division A/S (Pharmaceutical company). Phase: Therapeutic confirmatory (Phase III). Countries: Germany (authorised, recruiting), Spain (ongoing, recruiting), Italy (ongoing, recruiting), France (ongoing, recruiting), Romania (authorised, recruiting).
Therapeutic area(s): Diseases [C] - Musculoskeletal Diseases [C05]
Gender: Female, Male. Age: 0-17 years. Enrolment: 66.
Start date (EU): 2026-04-15. Decision date: 2026-02-27. Results received: No. Last updated: 2026-05-25.
Decision dates by country: FR: 2026-02-27, DE: 2026-03-03, IT: 2026-03-02, RO: 2026-03-09, ES: 2026-03-04

Condition(s): Turner Syndrome (TS), idiopathic short stature (ISS), short stature homeobox containing gene deficiency (SHOX-D), small for gestational age (SGA)
Product: Lonapegsomatropin, Lonapegsomatropin, Lonapegsomatropin, Lonapegsomatropin, Lonapegsomatropin, Lonapegsomatropin, Norditropin FlexPro, injektionsvæske, opløsning i fyldt pen, Lonapegsomatropin, Lonapegsomatropin, Lonapegsomatropin, Lonapegsomatropin, Lonapegsomatropin, Lonapegsomatropin, Lonapegsomatropin, Lonapegsomatropin

Primary endpoint: Annualized height velocity (AHV) at Week 52
Endpoint(s): AHV (Week 104), Change from baseline in height SDS (CDC-based) (Weeks 52 and 104), Change from baseline in height SDS (condition specific if applicable) (Weeks 52 and 104), Treatment-emergent adverse events (AEs), Safety labs, vital signs, physical exam, local tolerability assessments, and fundoscopy, Bone age (Weeks 52 and 104), Bone age:chronological age ratio (Weeks 52 and 104)

Source: https://euclinicaltrials.eu/ctis-public/view/2025-523079-44-00